EU clinical trial 2023-507413-10-00: An Open-Label Study to Evaluate the Long-Term Safety, Tolerability and Efficacy of OMS906 in Patients with Paroxysmal Nocturnal Hemoglobinuria (PNH)
Protocol code: OMS906-PNH-003
Sponsor: Omeros Corp. (Pharmaceutical company). Phase: Therapeutic exploratory (Phase II). Countries: Germany (ongoing, recruitment ended).
Therapeutic area(s): Diseases [C] - Hemic and Lymphatic Diseases [C15]
Gender: Female, Male. Age: 18-64 years, 65+ years. Enrolment: 4.
Status: Ongoing, recruitment ended. Start date (EU): 2024-07-16. Decision date: 2024-05-08. Results received: No. Last updated: 2026-04-10.

Condition(s): Paroxysmal Nocturnal Hemoglobinuria (PNH)

Primary endpoint: Safety and tolerability as assessed by adverse events (AEs), vital signs, electrocardiograms (ECGs), and clinical laboratory tests.
Endpoint(s): Efficacy as measured by: proportion of patients achieving Hb ≥ 12.0 g/dL assessed at 6-month intervals; proportion of patients maintaining an increase in Hb ≥ 2 g/dL, achieved in the prior study; proportion of patients who are transfusion free at Weeks 48 and 96; proportion of patients experiencing clinical BTH at Weeks 48 and 96; mean LDH and absolute reticulocyte changes from from baseline, start of the long-term extension, at Weeks 48 and 96; zaltenibart PK concentrations and PD parameters

Source: https://euclinicaltrials.eu/ctis-public/view/2023-507413-10-00